EU clinical trial 2024-513816-86-00: Efficacity of hypnosis versus premedication for the management of perioperative anxiety in gynecological surgery
Sponsor: CHRU De Nancy (Hospital/Clinic/Other health care facility). Phase: Therapeutic use (Phase IV). Countries: France (ended).
Therapeutic area(s): Diseases [C] - Female Urogenital Diseases and Pregnancy Complications [C13]
Gender: Female. Age: 18-64 years. Enrolment: 128.
Status: Ended. Start date (EU): 2018-04-25. End date (EU): 2026-03-05. Decision date: 2024-07-26. Results received: No. Last updated: 2025-11-04.

Condition(s): perioperative anxiety

Source: https://euclinicaltrials.eu/ctis-public/view/2024-513816-86-00